EU clinical trial 2025-521243-20-00: A Phase 2, Randomized, Double-blinded, Placebo-controlled, Dose Range-finding, Multicenter Study to Evaluate the Efficacy, Safety, and Pharmacokinetics of ALXN2420, a Growth Hormone Receptor Antagonist, Administered Subcutaneously in Combination with Somatostatin Analogs in Adult Participants with Acromegaly
Protocol code: ALXN2420-Acro-201
Sponsor: Alexion Pharmaceuticals Inc. (Pharmaceutical company). Phase: Therapeutic exploratory (Phase II). Countries: Lithuania (ended), Romania (ended), Denmark (ended), Italy (ended), Hungary (ended), Poland (ended), Netherlands (ended).
Therapeutic area(s): Diseases [C] - Hormonal diseases [C19]
Gender: Female, Male. Age: 18-64 years, 65+ years. Enrolment: 32.
Status: Ended. Start date (EU): 2025-10-23. End date (EU): 2026-06-24. End date: 2026-06-25. Decision date: 2025-09-29. Results received: No. Last updated: 2026-01-08.
Decision dates by country: DK: 2025-09-29, HU: 2025-10-03, IT: 2025-09-29, LT: 2025-09-29, RO: 2025-10-06, PL: 2025-10-06, NL: 2025-10-15

Condition(s): Acromegaly
Product: ALXN2420, OCTREOTIDE ACETATE, OCTREOTIDE ACETATE, LANREOTIDE ACETATE, LANREOTIDE ACETATE, matching placebo for ALXN2420, LANREOTIDE ACETATE, OCTREOTIDE ACETATE

Primary endpoint: Percentage change from baseline in serum IGF-1 level at Week 15
Endpoint(s): 1_Number of Participants Who Achieve Serum IGF-1 Level ≤1.3 Upper Limit of Normal (ULN) at Week 15, 2_Number of Participants Who Achieve Serum IGF-1 Level ≤1.0 ULN at Week 15, 3_Change From Baseline in Symptoms, as Assessed by disease specific questionnaire, at Week 15, 4_Change From Baseline in Serum IGF-1 Level at Week 15, 5_Change From Baseline in 36-item Short Form Survey (SF-36) Summary Scores and Subscores at Week 15, 6_Change From Baseline in EuroQol 5-Dimension 5-Level (EQ-5D-5L) at Week 15, 7_Change from baseline in Acromegaly Quality of Life (AcroQoL) at Week 15, 8_Change From Baseline in Global Impression of Severity at Week 15 as Assessed by Patient Global Impression of Severity (PGIS) Scale, 9_Global Impression of Change at Week 15 as Assessed by Patient Global Impression of Change (PGIC) Scale, 10_Number of Participants With Treatment-emergent Adverse Events (TEAEs), Treatment-emergent Serious Adverse Events (TESAEs), and Adverse Events (AEs) Leading to Study Intervention Discontinuation or Interruption through Week 15, 11_Plasma Concentration of ALXN2420 over time through Week 15, 12_Number of Participants With Antidrug Antibodies (ADAs) through Week 15

Source: https://euclinicaltrials.eu/ctis-public/view/2025-521243-20-00